EU clinical trial 2024-512217-40-00: An Open-label, Rollover Study of Futibatinib in Patients Previously Enrolled in an Antecedent Futibatinib Study
Protocol code: TAS-120-404
Sponsor: Taiho Oncology Inc. (Pharmaceutical company). Phase: Phase II and Phase III (Integrated). Countries: Sweden (authorised, recruitment pending), Portugal (authorised, recruitment pending), Spain (ongoing, recruiting), France (ongoing, recruiting).
Therapeutic area(s): Diseases [C] - Neoplasms [C04]
Gender: Female, Male. Age: 18-64 years, 65+ years. Enrolment: 5.
Start date (EU): 2024-10-11. Decision date: 2024-07-16. Results received: No. Last updated: 2025-08-26.
Decision dates by country: PT: 2024-07-16, ES: 2024-08-08, SE: 2024-07-16, FR: 2024-10-29

Condition(s): Malignant Solid Tumors
Product: Futibatinib, FULVESTRANT

Primary endpoint: Serious adverse events, treatment-related adverse events, and any AEs leading to treatment discontinuation graded according to NCI-CTCAE v5.0

Source: https://euclinicaltrials.eu/ctis-public/view/2024-512217-40-00